EU clinical trial 2023-505810-12-00: Prospective, randomized, double-blind, placebo-controlled, multicenter study to investigate the efficacy and safety of NT 201 in the treatment of lower limb spasticity caused by stroke or traumatic brain injury in adult subjects, followed by an open label extension with or without combined upper limb treatment
Protocol code: M602011014
Sponsor: Merz Pharmaceuticals GmbH (Pharmaceutical company). Phase: Therapeutic confirmatory (Phase III). Countries: France (ongoing, recruitment ended), Slovakia (ended), Italy (ended), Spain (ended), Poland (ongoing, recruitment ended), Germany (ongoing, recruitment ended), Hungary (ended), Belgium (ended), Czechia (ongoing, recruitment ended).
Therapeutic area(s): Diseases [C] - Nervous System Diseases [C10]
Gender: Female, Male. Age: 18-64 years, 65+ years. Enrolment: 343.
Start date (EU): 2019-09-03. Decision date: 2024-08-02. Results received: No. Last updated: 2026-03-24.
Decision dates by country: BE: 2024-08-02, CZ: 2024-08-06, FR: 2024-08-02, DE: 2024-08-02, HU: 2024-08-02, ES: 2024-08-05, SK: 2024-08-05, IT: 2024-08-07, PL: 2024-08-29

Condition(s): Lower limb spasticity
Product: XEOMIN 200 jednotek prášek pro injekční roztok, XEOMIN, 200 jednostek, proszek do sporządzania roztworu do wstrzykiwań, XEOMEEN 200 eenheden poeder voor oplossing voor injectie, XEOMIN 200 egység por oldatos injekcióhoz, XEOMIN 200 jednotiek prášok na injekčný roztok, XEOMIN 200 unidades polvo para solución inyectable, XEOMEEN 200 unités poudre pour solution injectable, XEOMIN 200 Einheiten Pulver zur Herstellung einer Injektionslösung, XEOMIN 200 unités, poudre pour solution injectable, XEOMIN, 200 unità, polvere per soluzione iniettabile, Placebo to NT 201

Primary endpoint: Change from baseline in derived MAS ankle score (knee extended) at Weeks 4 to 6 (using a value modelled from the actual values measured at Week 4 [V3] and Week 6 [V4]), GICS assessed by physician at Week 4 to 6 (using a value modelled from the actual values measured at Week 4 [V3] and Week 6 [V4]) (co-primary for US regulatory authority only, otherwise secondary)., Primary safety variable: • Occurrence of treatment emergent adverse events [TEAEs] in Main Period.
Endpoint(s): Key secondary efficacy variable: Change from Study Baseline in Goal Attainment Scale [GAS] at Week 6 (V4), GICS assessed by subject at Week 4 (V3) to Week 6 (V4), GICS assessed by caregiver at Week 4 (V3) to Week 6 (V4).

Source: https://euclinicaltrials.eu/ctis-public/view/2023-505810-12-00